EU clinical trial 2025-520557-36-00: A Phase 1, Open-Label Dose Escalation and Expansion study of SNV1521 in Participants with Advanced Solid Tumors
Protocol code: SNV1521-101
Sponsor: Synnovation Therapeutics Inc. (Pharmaceutical company). Phase: Human Pharmacology (Phase I)- First administration to humans. Countries: France (ongoing, recruiting), Italy (ongoing, recruiting), Spain (ongoing, recruiting), Belgium (authorised, recruitment pending).
Therapeutic area(s): Diseases [C] - Neoplasms [C04]
Gender: Female, Male. Age: 18-64 years, 65+ years. Enrolment: 79.
Start date (EU): 2025-07-24. Decision date: 2025-07-08. Results received: No. Last updated: 2026-06-03.
Decision dates by country: BE: 2025-12-23, IT: 2025-07-08, ES: 2025-07-24, FR: 2025-07-08

Condition(s): Advanced Solid Tumors

Source: https://euclinicaltrials.eu/ctis-public/view/2025-520557-36-00